EU clinical trial 2024-518057-41-00: The RIME-IVF study - Investigation of RIsk factors in out-of-hospital-cardiac-arrest patients, and MEdical treatment in Idiopathic Ventricular Fibrillation patients
Sponsor: Rigshospitalet (Hospital/Clinic/Other health care facility). Phase: Therapeutic use (Phase IV). Countries: Denmark (ongoing, recruiting).
Therapeutic area(s): Diseases [C] - Cardiovascular Diseases [C14]
Gender: Female, Male. Age: 18-64 years, 65+ years. Enrolment: 218.
Status: Ongoing, recruiting. Start date (EU): 2019-02-22. Decision date: 2024-10-23. Results received: No. Last updated: 2024-10-23.

Condition(s): Unexplained cardiac arrest patients after thorough investigations (Idiopathic ventricular fibrillation, IVF)
Product: BISOPROLOL, METOPROLOL, ATENOLOL, NADOLOL, PROPRANOLOL

Primary endpoint: Endpoint will be one of the following 1) first appropriate therapy by ICD, 2) aborted shock or non-sustained VF, where the treating physician opts XML File Identifier: kg77bYwzweR7n2lb9bLtT2kXLeo= Page 25/34 for a change in medication, or 3) 3 years after randomizationdischarge, whichever comes first.
Endpoint(s): Quality of life after 1 year

Source: https://euclinicaltrials.eu/ctis-public/view/2024-518057-41-00